EU clinical trial 2024-515987-29-00: KETamine sedation as neuroprotective agent following out-of-hospital cardiac arrest (OHCA) - the KETOHCA trial.
Sponsor: Rigshospitalet (Hospital/Clinic/Other health care facility). Phase: Phase III and phase IV (Integrated). Countries: Denmark (ongoing, recruiting).
Therapeutic area(s): Diseases [C] - Cardiovascular Diseases [C14]
Gender: Female, Male. Age: 18-64 years, 65+ years. Enrolment: 282.
Status: Ongoing, recruiting. Start date (EU): 2024-12-11. Decision date: 2024-10-01. Results received: No. Last updated: 2025-04-15.

Condition(s): Out-of-hospital cardiac arrest
Product: Propolipid, S-ketamin "Pfizer" injektionsvæske, opløsning

Primary endpoint: Neuron-specific enolase (NSE) measured 48 hours after OHCA
Endpoint(s): 1. Death from all causes at 180 days after cardiac arrest. 2. CPC- and mRS score at hospital discharge and 180-240 days after cardiac arrest.

Source: https://euclinicaltrials.eu/ctis-public/view/2024-515987-29-00